EU clinical trial 2025-521816-20-00: A Phase 2a, Randomized, Open-Label, Active-Controlled, Crossover Study to Evaluate Safety and Explore Efficacy of Different Doses of New Lipase NHS7108 Administered Orally in Participants with Exocrine Pancreatic Insufficiency.
Protocol code: 2307CLI
Sponsor: Aimmune Nestle Health Science US R&D LLC (Pharmaceutical company). Phase: Therapeutic exploratory (Phase II). Countries: Poland (authorised, recruitment pending), Hungary (authorised, recruiting), Spain (authorised, recruiting), Bulgaria (authorised, recruitment pending), Italy (authorised, recruiting).
Therapeutic area(s): Diseases [C] - Nutritional and Metabolic Diseases [C18]
Gender: Female, Male. Age: 18-64 years, 65+ years. Enrolment: 29.
Start date (EU): 2026-06-29. Decision date: 2026-05-18. Results received: No. Last updated: 2026-08-03.
Decision dates by country: BG: 2026-05-20, HU: 2026-05-18, PL: 2026-05-25, IT: 2026-05-20, ES: 2026-05-19

Condition(s): Exocrine Pancreatic Insufficiency
Product: Zenpep delayed-release capsule, NHS7108 capsules

Primary endpoint: 1. Number of participants reporting 1 or more adverse events (AE), 2. Changes from baseline in safety parameters including clinical laboratory tests, vital signs, 12-lead electrocardiogram (ECG), and physical examination after 14-day NHS7108 treatment, 3. Change from baseline in the CNA after 14-day NHS7108 treatment
Endpoint(s): 1. Change from baseline in the coefficient of fat absorption (CFA) after 14-day NHS7108 treatment as compared to Zenpep®, 2. Omega-3 absorption test: change from baseline in post-prandial eicosapentaenoic acid (EPA) and docosahexaenoic acid (DHA) content of plasma over a 24-hour period following a standard breakfast after 14 day NHS7108 treatment, 3. Change from baseline in the GI symptoms score (included in the eDiary) after 14-day NHS7108 treatment, 4. Stool frequency as assessed by the eDiary, 5. Stool consistency as assessed by the Bristol Stool Scale (included in the eDiary)

Source: https://euclinicaltrials.eu/ctis-public/view/2025-521816-20-00